EU clinical trial 2025-521456-35-00: A Phase II, multinational, multicentre, double-blind, randomised, active-controlled, 3-way cross-over study to evaluate the therapeutic equivalence of CHF5993 pMDI 100/6/12.5 µg HFA-152a versus CHF5993 pMDI 100/6/12.5 µg HFA-134a in subjects with mild to moderate asthma. [TRECONY]
Protocol code: CLI-05993AA9-01
Sponsor: Chiesi Farmaceutici S.p.A. (Pharmaceutical company). Phase: Therapeutic exploratory (Phase II). Countries: Slovakia (ongoing, recruiting), Czechia (ongoing, recruiting), Romania (ongoing, recruiting), Latvia (ongoing, recruiting), Germany (ongoing, recruiting), Hungary (ongoing, recruiting), Bulgaria (ongoing, recruiting), Poland (ongoing, recruiting).
Therapeutic area(s): Diseases [C] - Respiratory Tract Diseases [C08]
Gender: Female, Male. Age: 18-64 years, 65+ years. Enrolment: 250.
Status: Ongoing, recruiting. Start date (EU): 2026-04-13. Decision date: 2026-03-11. Results received: No. Last updated: 2026-05-11.
Decision dates by country: BG: 2026-03-12, CZ: 2026-03-11, HU: 2026-03-12, LV: 2026-03-11, PL: 2026-05-11, SK: 2026-03-10, RO: 2026-03-16, DE: 2026-03-12

Condition(s): Mild to moderate asthma
Product: CHF5993 pMDI (100) -152a, CHF5993 pMDI HFA-152a, Trimbow 87 micrograms/5 micrograms/9 micrograms pressurised inhalation, solution

Primary endpoint: • Change from baseline in FEV1 AUC0-4h on Day 1 • Change from baseline in pre-dose FEV1 on Day 28
Endpoint(s): Relative and absolute change from pre-dose FEV1 at all post-dose timepoints at each visit, Number and percentage of subjects with a >15% relative decrease from pre-dose in FEV1 at any post-dose timepoint at each visit, Change from pre-dose FEV1 area under the curve from time 0 to 2 h (AUC0-2h) on Day 28, Change from baseline (Day 1) in ACQ-7 scores on Day 28, Average daily use of rescue medication (number of puffs/day), percentage of days without intake of rescue medication and percentage of asthma control days during the TP, Average morning and evening PEF and average daily symptoms during TP

Source: https://euclinicaltrials.eu/ctis-public/view/2025-521456-35-00